EU clinical trial 2023-507748-35-00: Study of KITE-222 in Participants With Relapsed/Refractory Acute Myeloid Leukemia
Protocol code: KT-US-486-0201
Sponsor: Kite Pharma Inc. (Pharmaceutical company). Phase: Human Pharmacology (Phase I)- First administration to humans. Countries: France (ended), Germany (ended).
Therapeutic area(s): Diseases [C] - Neoplasms [C04]
Gender: Female, Male. Age: 18-64 years, 65+ years. Enrolment: 10.
Status: Ended. Start date (EU): 2022-11-08. End date (EU): 2024-05-18. End date: 2024-05-19. Decision date: 2023-10-05. Results received: No. Last updated: 2024-07-02.
Decision dates by country: FR: 2023-10-05, DE: 2023-10-19

Condition(s): Acute Myeloid Leukemia

Source: https://euclinicaltrials.eu/ctis-public/view/2023-507748-35-00